EU clinical trial 2023-503477-38-00: Insemination in patients with polycystic ovary syndrome: gestation rates using two stimulation patterns: letrozole vs gonadotropins.
Protocol code: LEGOIN
Sponsor: Hospital Universitario La Paz (Hospital/Clinic/Other health care facility). Phase: Therapeutic confirmatory (Phase III). Countries: Spain (ongoing, recruiting).
Therapeutic area(s): Diseases [C] - Female Urogenital Diseases and Pregnancy Complications [C13]
Gender: Female. Age: 18-64 years. Enrolment: 100.
Status: Ongoing, recruiting. Start date (EU): 2023-12-15. Decision date: 2023-10-09. Results received: No. Last updated: 2023-10-09.

Condition(s): Insemination in patients with polycystic ovary syndrome
Product: GONAL-f 450 IU/0.75 mL powder and solvent for solution for injection, LETROZOLE, Ovaleap 450 IU/0.75 mL solution for injection, Puregon 600 IU/0.72 mL solution for injection, Bemfola 75 IU/0.125 mL solution for injection in pre-filled pen

Primary endpoint: The gestation rate is calculated as the number of gestations (determined as positive urine pregnancy test between the 15th-17th day of insemination) per insemination performed., The rate of new borns is calculated as the number of newborns per insemination performed.
Endpoint(s): Number of dominant follicles recruited, defined as the number of follicles larger than 14 mm visualized on the last day of ultrasound control performed on the patient prior to insemination., Cancellation due to non-response (defined as no response to stimulation treatment after 28 days of stimulation, defined as the non-observation of dominant follicles (larger than 14 mm) on vaginal ultrasound., Cancellation due to hyperresponse (defined as the presence of 3 or more follicles larger than 14mm on the day of ultrasound control)., Abortion rate: defined as the loss of pregnancy before 20 weeks of gestational age per gestation achieved., Biochemical pregnancy rate defined as the termination of a pregnancy before the gestational sac is detected by ultrasound., Insulin resistance: Peripheral insulin resistance is calculated using the formula HOMA IR= IB*GB/22.5. Its cut-off point is 3.8. or a glucose overload of 75 gr positive. A test is performed with 75 gr. of glucose administered on an empty stomach and controlled blood glucose levels at two hours. If the value is between 140 and 199 mg/dl then it is called Glucose Intolerance., BMI: is calculated by dividing the kilograms of weight by the square of the height in meters (BMI = weight (kg)/ [height (m)]2, Antimullerian hormone: the determination of AMH (ECLIA Roche Diagnostics), Incidence of gestational diabetes, Perinatal data, Route of delivery: eutocic, instrumental o cesarean, Newborn weight, Days of stimulation: stimulation days defined as the number of days until ovulatory discharge.

Source: https://euclinicaltrials.eu/ctis-public/view/2023-503477-38-00